EU clinical trial 2024-514868-11-00: Effect of Dapagliflozin on myocardial and renal function following aortic valve stenosis intervention
Sponsor: Region Midtjylland (Hospital/Clinic/Other health care facility). Phase: Phase II and Phase III (Integrated). Countries: Denmark (ongoing, recruitment ended).
Therapeutic area(s): Diseases [C] - Cardiovascular Diseases [C14]
Gender: Female, Male. Age: 18-64 years, 65+ years. Enrolment: 76.
Status: Ongoing, recruitment ended. Start date (EU): 2024-07-04. Decision date: 2024-07-04. Results received: No. Last updated: 2026-05-27.

Condition(s): Aortic stenosis
Product: Forxiga 10 mg film-coated tablets, Placebo consisting of Glucosemonohydrat Ph. Eur. encapsuled in a DB AAel capsule.

Primary endpoint: Changes from baseline to 12 months of follow-up in at least 2 out of 4 well-known parameters of performance in AS is required to reach the primary endpoint. The level of change, in percentage points (%P), is considered clinically significant based on existing litterature: • LVMi reduction of 10 % point (by CMRI) • LV GLS absolute increase of 2.0 % point (by TTE) • A decrease in serum Nt-proBNP of more than 25% • Relative increase of 10% in eGFR
Endpoint(s): 1. Difference in the change in eGFR from baseline to 12-months, 2. Difference in eGFR at 12-months., 3. The number of patients with a relative difference of 10 % of myocardial interstitial fibrosis evaluated by the biomarker extracellular volume (ECV) by late enhancement gadolinium by CMR, 4. The number of patients with a >10% decrease in cardiac fibrosis when assessed by CMR using native T1-mapping., 5. Composite endpoint of worsening HF with hospitalization or urgent outpatient clinical visit due to HF, and all-cause mortality, 6. All-cause mortality, 7. Worsening HF with hospitalization or urgent outpatient clinical visit due to HF, 8. Difference in the change in urinary albumin/creatinine ratio (ACR) from baseline to 12-months., 9. Difference in ACR at 12-months., 10. 24-hour ambulatory blood pressure changes from baseline to 12 months., 11. Change from baseline to 12-months follow-up in the KCCQ Total Symptom Score, 12. Change from baseline to 12-months follow-up in NYHA-class, 13. LVMi reduction of 10 % point (by CMRI) from baseline to 12-months follow-up, 14. LV GLS absolute increase of 2.0 % point (by TTE) from baseline to 12-months follow-up, 15. A decrease in serum Nt-proBNP of more than 25% from baseline to 12-months follow-up, 16. Relative increase of 10% in eGFR measured at baseline and 12-months

Source: https://euclinicaltrials.eu/ctis-public/view/2024-514868-11-00